EU clinical trial 2024-511884-27-00: A Phase I/Ib, open-label, dose finding study to assess the safety, tolerability, pharmacokinetics, and preliminary efficacy of OBT076, a CD205-directed antibody-drug conjugate, in recurrent and/or metastatic CD205-positive solid tumors
Protocol code: OBT076-001
Sponsor: Oxford Biotherapeutics Limited (Pharmaceutical company). Phase: Human Pharmacology (Phase I)- Other. Countries: France (ongoing, recruiting), Spain (ongoing, recruiting), Greece (ongoing, recruiting), Belgium (ongoing, recruiting).
Therapeutic area(s): Diseases [C] - Neoplasms [C04]
Gender: Female, Male. Age: 18-64 years, 65+ years. Enrolment: 180.
Status: Ongoing, recruiting. Start date (EU): 2022-11-09. Decision date: 2024-05-21. Results received: No. Last updated: 2026-06-11.
Decision dates by country: GR: 2024-05-23, BE: 2024-05-23, ES: 2024-05-23, FR: 2024-05-21

Condition(s): CD205+ve recurrent and/or metastatic tumor types including but not limited to gastric cancer, NSCLC, endometrial or ovarian cancer. Other tumor types may be added as more data become available.
Product: OBT076, Ribozar 200 mg Pulver zur Herstellung einer Infusionslösung

Primary endpoint: safety endpoints: DLTs and MTD evaluated using the NCI CTCAE criteria, Version 5 Characterize safety and tolerability
Endpoint(s): Preliminary efficacy : CBR determined by response and stable disease rates by disease-appropriate response criteria, ORR, DoR, PFS, and OS Efficacy of OBT076 followed by balstilimab Potential re-sensitization to checkpoint inhibitors (CPI) in CPI failure patients (overall and by anti-PD-1 pre-treatment status) Efficacy of OBT076 in combination with balstilimab as determined by iORR, iDoR, iCBR, iPFS and iOS, PK Endpoints :Maximum observed plasma concentration (Cmax), area under the plasma concentration time-curve (AUC), time to maximum observed plasma concentration (Tmax), terminal half-life (t1/2)

Source: https://euclinicaltrials.eu/ctis-public/view/2024-511884-27-00